EU clinical trial 2025-524008-32-00: A phase 2a exploratory study of TAR-0520 gel in prevention of Hand and Foot Syndrome
Sponsor: Tarian Pharma (Pharmaceutical company). Phase: Therapeutic exploratory (Phase II). Countries: France (authorised, recruitment pending).
Therapeutic area(s): Diseases [C] - Skin and Connective Tissue Diseases [C17]
Gender: Female, Male. Age: 18-64 years, 65+ years. Enrolment: 25.
Status: Authorised, recruitment pending. Decision date: 2026-02-16. Results received: No. Last updated: 2026-02-16.

Condition(s): Capecitabine-induced hand and foot syndrome
Product: TAR-0520 Gel

Primary endpoint: Incidence of Adverse Events, Adverse Events of Special Interest and Serious Adverse Events
Endpoint(s): Incidence and severity of NCI-CTCAE (Palmar-plantar erythrodysesthesia syndrome) grading by oncologist

Source: https://euclinicaltrials.eu/ctis-public/view/2025-524008-32-00